EU clinical trial 2024-516033-12-00: Colchicine after Electrocardioversion for Atrial Fibrillation - The COLECTRO-AF Trial
Protocol code: COLECTRO-AF
Sponsor: Universitaetsspital Basel (Hospital/Clinic/Other health care facility). Phase: Therapeutic confirmatory (Phase III). Countries: Germany (authorised, recruitment pending).
Therapeutic area(s): Diseases [C] - Cardiovascular Diseases [C14]
Gender: Female, Male. Age: 18-64 years, 65+ years. Enrolment: 1.
Status: Authorised, recruitment pending. Decision date: 2026-06-26. Results received: No. Last updated: 2026-06-26.

Condition(s): Atrial Fibrillation
Product: Placebo Colchicine 0.5 mg tablets are cream-white, circular tablets, with a diameter of 6 mm, thickness of 3 mm, with “0,5” engraved on one side. With the exception of the active ingredient (Colchicine) for the placebo IMP, the components of the active and placebo tablets are identical (see Table 1 on page 9 in IMPD for more info)., Colctab 0,5 mg Tabletten

Primary endpoint: Documented AF recurrences within 6 months after ECV in patients with AF.
Endpoint(s): Documented AF recurrences within 1 month after ECV, Documented AF recurrences within 3 months after ECV, Time to first redo ECV, Use of anti-arrhythmic drugs (Vaughan Williams class 1 or 3) at 6 months, Survival free of unplanned hospitalization

Source: https://euclinicaltrials.eu/ctis-public/view/2024-516033-12-00